EU clinical trial 2023-504751-28-00: Vitrectomy, subretinal Tissue plasminogen activator and Intravitreal Gas for submacular haemorrhage secondary to Exudative age-Related macular degeneration (TIGER): a phase 3, pan-European, two-group, active-control, observer-masked, superiority, randomised controlled surgical trial.
Protocol code: TIGER
Sponsor: King's College London, King's College Hospital NHS Foundation Trust (Educational Institution, Hospital/Clinic/Other health care facility). Phase: Therapeutic confirmatory (Phase III). Countries: Germany (ongoing, recruiting), Ireland (ongoing, recruiting), Poland (ongoing, recruiting), Netherlands (authorised, recruitment pending), Spain (authorised, recruitment pending).
Therapeutic area(s): Diseases [C] - Eye Diseases [C11]
Gender: Female, Male. Age: 18-64 years, 65+ years. Enrolment: 51.
Start date (EU): 2024-09-24. Decision date: 2023-11-20. Results received: No. Last updated: 2026-06-29.
Decision dates by country: DE: 2023-11-20, IE: 2025-02-07, PL: 2025-03-09, NL: 2025-03-26, ES: 2026-04-06

Condition(s): Exudative age-related macular degeneration
Product: Actilyse 10 mg powder and solvent for solution for injection and infusion, AFLIBERCEPT

Primary endpoint: Gain of at least 10 ETDRS letters in BCVA in the study eye at the month 12 visit.
Endpoint(s): Gain of at least 10 ETDRS letters (month 6), Mean ETDRS BCVA., Radner reading vision., National Eye Institute 25 item Visual Function Questionnaire composite score., Scotoma size (Humphrey Field Analyser 10-2), Presence/absence of subfoveal fibrosis and/or atrophy and area of fibrosis/atrophy using multimodal reading centre image analysis (month 12).

Source: https://euclinicaltrials.eu/ctis-public/view/2023-504751-28-00